EU clinical trial 2024-511023-34-00: AIPAC-003: A randomized, double-blind, placebo-controlled Phase 3 trial testing eftilagimod alpha (soluble LAG-3) in HER2-neg/low metastatic breast cancer patients receiving paclitaxel, following an open-label dose optimization
Protocol code: IMP321-P016
Sponsor: Immutep (Pharmaceutical company). Phase: Phase II and Phase III (Integrated). Countries: Spain (ended), Belgium (ended).
Therapeutic area(s): Diseases [C] - Neoplasms [C04]
Gender: Female, Male. Age: 18-64 years, 65+ years. Enrolment: 99.
Status: Ended. Start date (EU): 2023-05-05. End date (EU): 2026-06-30. Decision date: 2024-06-24. Results received: No. Last updated: 2026-04-07.
Decision dates by country: ES: 2024-06-24, BE: 2024-06-25

Condition(s): HER2-neg/low metastatic breast cancer
Product: IMP321 Placebo, IMP321, PACLITAXEL

Primary endpoint: DOSE OPTIMIZATION LEAD-IN • Frequency, severity, and duration of adverse events (AEs). • Clinically relevant abnormalities in vital signs, physical examinations, 12-lead ECGs, and safety laboratory assessments. • Occurrence of dose-limiting toxicities (DLTs). • Determination of the OBD., PHASE 3 • Overall survival (OS) is defined as the time from randomization to death from any cause.
Endpoint(s): DOSE OPTIMIZATION LEAD-IN • Objective response rate (ORR) according to RECIST 1.1 by investigator assessment defined as the proportion of patients who have best overall response (BOR) of CR or PR., • Progression free survival (PFS) per RECIST 1.1, defined as the timefrom the date of first treatment to documented disease progression or death from any cause as assessed by the investigator assessment based on RECIST 1.1. Censuring rules as per FDA guideline. ., • Overall survival (OS) is defined as the time from the date of first treatment to death from any cause. Patients who are lost to follow-up and those who are alive at the date of data cut-off will be censored at the last date the patient was last known alive, or date of data cut-off, whichever occurs first., • Changes from baseline in quality of life (QOL) as assessed by EORTC QLQ-C30 over the course of the trial., • Plasma concentration time profile and derived PK parameters of efti at 30 and 90 mg (dose optimization lead-in only) dose levels., • Progression free survival (PFS) per RECIST 1.1, defined as the time from randomization to documented disease progression or death from any cause as assessed by the investigator assessment based on RECIST 1.1. Censuring rules as per FDA guideline., • Objective response rate (ORR) according to RECIST 1.1 by investigator assessment defined as the proportion of patients who have best overall response (BOR) of CR or PR., • Frequency, severity, and duration of adverse events (AEs), • Clinically relevant abnormalities in vital signs, physical examinations, 12-lead ECGs, and safety laboratory assessments.

Source: https://euclinicaltrials.eu/ctis-public/view/2024-511023-34-00